EU clinical trial 2023-505683-11-00: A study in healthy men to test how BI 1291583 is taken up by the body
Protocol code: 1397-0026
Sponsor: Boehringer Ingelheim International GmbH (Pharmaceutical company). Phase: Human Pharmacology (Phase I)- Other. Countries: Netherlands (ended).
Therapeutic area(s): Not possible to specify
Gender: Male. Age: 18-64 years. Enrolment: 25.
Status: Ended. Start date (EU): 2023-12-12. End date (EU): 2024-02-07. Decision date: 2023-11-10. Results received: No. Last updated: 2023-12-14.

Condition(s): Healthy volunteer trial

Source: https://euclinicaltrials.eu/ctis-public/view/2023-505683-11-00